EU clinical trial 2023-509771-17-00: A randomized, open label, multicenter phase II/III trial of sacituzumab govitecan compared to standard of care in metastatic, refractory colorectal cancer patients (TROPHIT1)
Protocol code: NCT_GI_BCK_01
Sponsor: Universitaetsklinikum Heidelberg AöR (Hospital/Clinic/Other health care facility). Phase: Phase II and Phase III (Integrated). Countries: Germany (ended).
Therapeutic area(s): Diseases [C] - Neoplasms [C04]; Diseases [C] - Digestive System Diseases [C06]
Gender: Female, Male. Age: 18-64 years, 65+ years. Enrolment: 80.
Status: Ended. Start date (EU): 2024-06-04. End date (EU): 2026-03-10. Decision date: 2024-04-22. Results received: No. Last updated: 2025-01-21.

Condition(s): Metastatic Colorectal cancer (mCRC)
Product: REGORAFENIB, TRIFLURIDINE, COMBINATIONS, SACITUZUMAB GOVITECAN, BEVACIZUMAB

Primary endpoint: Progression Free Survival (PFS): as the time from C1D1 (in part 1) or randomization (in part 2) into the study to time of progression of the disease or death from any cause, whatever occurs first.
Endpoint(s): Overall Survival (OS): as time from C1D1 (in part 1) or randomization (in part 2) until death or end of study (EOS)., Overall Response rate (ORR): Partial Response (PR) or Complete Response (CR), Disease Control Rate (DCR): Complete Response (CR), Partial Response (PR) or Stable Disease (SD), Duration of Response (DOR): as time from achievement of PR/CR until recurrence or progression of the disease or death from any cause

Source: https://euclinicaltrials.eu/ctis-public/view/2023-509771-17-00